EU clinical trial 2024-515885-15-00: CD8 PET imaging in metastatic solid tumours; A phase II, open label, multi-center study of 89Zr-DF-crefmirlimab for CD8 positron emission tomography in patients with locally advanced or metastatic solid tumors
Protocol code: 10353
Sponsor: Universitair Medisch Centrum Groningen (Hospital/Clinic/Other health care facility). Phase: Phase I and Phase II (Integrated)- Other. Countries: Netherlands (ongoing, recruiting), Spain (authorised, recruitment pending).
Therapeutic area(s): Diseases [C] - Neoplasms [C04]
Gender: Female, Male. Age: 18-64 years, 65+ years. Enrolment: 23.
Start date (EU): 2025-03-04. Decision date: 2024-11-29. Results received: No. Last updated: 2026-02-24.
Decision dates by country: NL: 2024-11-29, ES: 2026-02-24

Condition(s): Patients with metastatic solid tumours, where clinical data has shown a rationale for ICI therapy.
Product: OPDIVO 10 mg/mL concentrate for solution for infusion., JNJ-63723283, Zr89

Primary endpoint: Evaluation of 89Zr-Df-crefmirlimab biodistribution in cancer patients on the PET images at baseline and during anti-PD-1 antibody therapy., Assessment of the pharmacokinetic properties of 89Zr-Df-crefmirlimab in patients prior to and during treatment with an anti-PD-1 antibody, Baseline and on-treatment 89Zr-Df-crefmirlimab uptake in tumours (expressed as standardized uptake value), CD8 expression in tumour biopsy samples, as determined by IHC., Tumour volumetry, mpMRI parameters and MRI based texture metrics at baseline and during anti-PD-1 antibody therapy.
Endpoint(s): Local and systemic signs and symptoms of infusion reactions, incidence of adverse events per NCI CTCAE v5.0 criteria, changes in laboratory test results, vital signs and 12-lead electrocardiogram (ECG) findings., mpMRI parameters such as Ktrans derived from DCE-MRI; f, D derived from IVIM-DWI and DDKI and K derived from DK-MRI with tumour and immune cell CD8 expression as well as T cell infiltration., 89Zr-Df-crefmirlimab PET measurements (expressed as standardized uptake values) with radiologic response to treatment, according to (i)RECIST v1.1 criteria.

Source: https://euclinicaltrials.eu/ctis-public/view/2024-515885-15-00